EU clinical trial 2024-516379-34-00: Investigator led, double-masked, multicentre, randomized clinical trial for the comparison of atropine 0.5% versus atropine 0.05% eye drops for the prevention of myopia progression in Dutch children
Protocol code: 7098
Sponsor: Erasmus Universitair Medisch Centrum Rotterdam (Erasmus MC) (Hospital/Clinic/Other health care facility). Phase: Therapeutic use (Phase IV). Countries: Netherlands (ongoing, recruitment ended).
Therapeutic area(s): Diseases [C] - Eye Diseases [C11]
Gender: Female, Male. Age: 0-17 years. Enrolment: 550.
Status: Ongoing, recruitment ended. Start date (EU): 2024-08-02. Decision date: 2024-08-02. Results received: No. Last updated: 2026-04-30.

Condition(s): Myopia
Product: Atropine 1.0% eye drops solution

Primary endpoint: To compare the efficacy of atropine 0.05% to atropine 0.5% treatment against progression of AL in children with progressive myopia.
Endpoint(s): To compare the efficacy of atropine 0.05% to atropine 0.5% treatment against progression of SER (Spherical Equivalent of Refraction) in children with progressive myopia., To evaluate the safety, adherence, and reasons for nonresponse of atropine 0.05% compared to atropine 0.5% treatment, To evaluate the rebound effect after treatment-stop.

Source: https://euclinicaltrials.eu/ctis-public/view/2024-516379-34-00